EU clinical trial 2024-514837-39-00: PILOT STUDY OF THE EFFECT OF A SUBSTANCE P ANTAGONIST, APREPITANT, ON THE SECRETION OF ALDOSTERONE IN PATIENTS WITH OBSTRUCTIVE SLEEP APNEA AND ARTERIAL HYPERTENSION SYNDROME - (APHOS3)
Protocol code: 2020/0431/HP
Sponsor: Centre Hospitalier Universitaire Rouen (Hospital/Clinic/Other health care facility). Phase: Therapeutic confirmatory (Phase III). Countries: France (ongoing, recruiting).
Therapeutic area(s): Diseases [C] - Nutritional and Metabolic Diseases [C18]
Gender: Female, Male. Age: 18-64 years, 65+ years. Enrolment: 24.
Status: Ongoing, recruiting. Start date (EU): 2024-07-01. Decision date: 2024-07-01. Results received: No. Last updated: 2026-03-18.

Condition(s): Patients with obstructive sleep apnea syndrome with arterial hypertension
Product: LACTOSE MONOHYDRATE, EMEND 125 mg+80 mg hard capsules

Primary endpoint: 24-hour aldosteronuria measurements. At the beginning and end of each treatment period.
Endpoint(s): blood pressure measurements, aldosteronemia, reninemia, plasma and urinary electrolytes, 24-hour plasma and urinary cortisol, plasma ACTH. At the beginning and end of each treatment period.

Source: https://euclinicaltrials.eu/ctis-public/view/2024-514837-39-00